EU clinical trial 2023-508270-29-01: A Study to Evaluate the Effects of Various Degrees of Hepatic Impairment on the Pharmacokinetics of A Single Subcutaneous Dose Of RO7434656, an Antisense Inhibitor of Complement Factor B
Protocol code: WA45032
Sponsor: F. Hoffmann-La Roche AG (Pharmaceutical company). Phase: Human Pharmacology (Phase I)- Other. Countries: Slovakia (ended), Germany (ended), Poland (ended).
Therapeutic area(s): Diseases [C] - Nutritional and Metabolic Diseases [C18]
Gender: Female, Male. Age: 18-64 years, 65+ years. Enrolment: 36.
Status: Ended. Start date (EU): 2024-09-24. End date (EU): 2025-10-07. End date: 2025-10-08. Decision date: 2024-07-31. Results received: No. Last updated: 2025-02-21.
Decision dates by country: PL: 2024-08-30, DE: 2024-07-31, SK: 2024-08-22

Condition(s): Hepatic Impairment

Source: https://euclinicaltrials.eu/ctis-public/view/2023-508270-29-01